EU clinical trial 2024-513087-26-00: A Randomized, Double-blind, Multiregional Phase 3 Study of Ivonescimab Combined with Chemotherapy Versus Pembrolizumab Combined with Chemotherapy for the First-line Treatment of Metastatic Non-small Cell Lung Cancer (HARMONi-3)
Protocol code: SMT112-3003
Sponsor: Summit Therapeutics Inc. (Pharmaceutical company). Phase: Therapeutic confirmatory (Phase III). Countries: France (ongoing, recruitment ended), Spain (ongoing, recruitment ended), Ireland (ongoing, recruitment ended), Greece (ongoing, recruitment ended), Germany (ongoing, recruitment ended), Italy (ongoing, recruitment ended), Poland (ongoing, recruitment ended), Belgium (ongoing, recruitment ended), Sweden (ongoing, recruitment ended).
Therapeutic area(s): Diseases [C] - Neoplasms [C04]
Gender: Female, Male. Age: 18-64 years, 65+ years. Enrolment: 661.
Status: Ongoing, recruitment ended. Start date (EU): 2024-09-10. Decision date: 2024-08-16. Results received: No. Last updated: 2026-05-08.
Decision dates by country: IE: 2024-08-23, DE: 2024-11-01, FR: 2024-10-29, PL: 2024-11-25, SE: 2025-05-12, BE: 2025-05-28, ES: 2024-08-16, IT: 2024-11-25, GR: 2024-08-22

Condition(s): Metastatic Non-small Cell Lung Cancer
Product: KEYTRUDA 25 mg/mL concentrate for solution for infusion, ivonescimab, Paclitaxel Ribosepharm 6 mg/ml Konzentrat zur Herstellung einer Infusionslösung, Carboplatin 10 mg/ml concentrate for solution for infusion, Abraxane 5 mg/ml powder for dispersion for infusion., Pazenir 5 mg/ml powder for dispersion for infusion., ALIMTA 500 mg powder for concentrate for solution for infusion

Primary endpoint: Overall Survival (OS), PFS assessed by IRRC based on RECIST v1.1
Endpoint(s): ORR and DoR assessed by IRRC based on RECIST v1.1, Safety assessment: incidence and severity of adverse events (AEs) and clinically significant abnormal laboratory test results, PK characteristics: ivonescimab serum drug concentrations profiles, Immunogenicity: number and percentage of patients with detectable anti-ivonescimab antibody (ADA) at baseline and post treatment

Source: https://euclinicaltrials.eu/ctis-public/view/2024-513087-26-00